EU clinical trial 2023-507630-25-00: An exploratory study to investigate the effect of FE 999302 when given together with follitropin delta during controlled ovarian stimulation
Protocol code: 000426
Sponsor: Ferring Pharmaceuticals A/S (Pharmaceutical company). Phase: Human Pharmacology (Phase I)- Other. Countries: Norway (ended), Spain (ended), Denmark (ended), Czechia (ended), Belgium (ended).
Therapeutic area(s): Diseases [C] - Female Urogenital Diseases and Pregnancy Complications [C13]
Gender: Female. Age: 18-64 years. Enrolment: 600.
Status: Ended. Start date (EU): 2024-06-14. End date (EU): 2025-09-05. Decision date: 2024-05-22. Results received: No. Last updated: 2025-07-04.
Decision dates by country: ES: 2024-05-22, BE: 2024-05-23, DK: 2024-05-22, NO: 2024-05-24, CZ: 2024-05-24

Condition(s): Infertility in women undergoing assisted reproductive technologies (ART)

Source: https://euclinicaltrials.eu/ctis-public/view/2023-507630-25-00